EU clinical trial 2023-505801-17-00: Pharmacokinetic comparison of efanesoctocog alfa vs other EHL-rFVIII products in participants with severe haemophilia A
Protocol code: Sobi.BIVV001-003
Sponsor: Swedish Orphan Biovitrum AB (publ) (Pharmaceutical company). Phase: Human Pharmacology (Phase I)- Bioequivalence Study. Countries: Germany (ended), Spain (ended), Italy (ended), Bulgaria (ended).
Therapeutic area(s): Diseases [C] - Congenital, Hereditary, and Neonatal Diseases and Abnormalities [C16]
Gender: Male. Age: 18-64 years. Enrolment: 36.
Status: Ended. Start date (EU): 2025-01-15. End date (EU): 2026-05-21. Decision date: 2024-04-03. Results received: No. Last updated: 2026-06-01.
Decision dates by country: DE: 2024-04-05, IT: 2024-04-04, ES: 2024-04-03, BG: 2025-12-18

Condition(s): Haemophilia A

Source: https://euclinicaltrials.eu/ctis-public/view/2023-505801-17-00